EU clinical trial 2023-507438-25-00: Study which tests 3 medicines (SB27, EU sourced Keytruda, and US sourced Keytruda) in early or locally advanced non-small cell lung cancer patients who underwent surgery and adjuvant chemotherapy
Protocol code: SB27-1005
Sponsor: Samsung Bioepis Co. Ltd. (Pharmaceutical company). Phase: Human Pharmacology (Phase I)- Bioequivalence Study. Countries: Spain (ended), Poland (ongoing, recruitment ended).
Therapeutic area(s): Diseases [C] - Neoplasms [C04]
Gender: Female, Male. Age: 18-64 years, 65+ years. Enrolment: 41.
Start date (EU): 2024-02-28. Decision date: 2024-01-19. Results received: No. Last updated: 2026-02-22.
Decision dates by country: PL: 2024-05-06, ES: 2024-01-19

Condition(s): Non-small cell lung cancer

Source: https://euclinicaltrials.eu/ctis-public/view/2023-507438-25-00